EU clinical trial 2024-512803-37-00: A double blind, randomized, placebo-controlled trial evaluating the efficacy and safety of BI 1015550 over at least 52 weeks in patients with Progressive Fibrosing Interstitial Lung Diseases (PF-ILDs)
Protocol code: 1305-0023
Sponsor: Boehringer Ingelheim International GmbH, Boehringer Ingelheim Espana S.A. (Pharmaceutical company). Phase: Therapeutic confirmatory (Phase III). Countries: Netherlands (ended), Greece (ended), Slovenia (ended), Germany (ended), Hungary (ended), France (ended), Norway (ended), Spain (ended), Sweden (ended), Finland (ended), Croatia (ended), Czechia (ended), Denmark (ended), Estonia (ended), Belgium (ended), Austria (ended), Italy (ended), Portugal (ended), Poland (ended).
Therapeutic area(s): Diseases [C] - Respiratory Tract Diseases [C08]
Gender: Female, Male. Age: 65+ years. Enrolment: 303.
Status: Ended. Start date (EU): 2022-10-05. End date (EU): 2025-04-01. End date: 2025-04-14. Decision date: 2024-09-18. Results received: Yes. Last updated: 2025-05-19.
Decision dates by country: BE: 2024-09-18, HR: 2024-09-19, CZ: 2024-09-19, DK: 2024-09-20, EE: 2024-09-23, FI: 2024-09-18, HU: 2024-09-18, IT: 2024-10-21, SI: 2024-09-30, ES: 2024-09-18, SE: 2024-09-19, NL: 2024-09-19, GR: 2024-09-20, NO: 2024-09-19, PT: 2024-11-04, DE: 2024-09-19, PL: 2024-10-07, AT: 2024-09-29, FR: 2024-09-18

Condition(s): Progressive Fibrosing Interstitial Lung Diseases (PF-ILDs)
Product: BI 1015550, Placebo matching BI 1015550, BI 1015550

Primary endpoint: Absolute change from baseline in Forced Vital Capacity (FVC) [mL] at Week 52
Endpoint(s): Key secondary endpoint: Time to the first occurrence of any of the components of the composite endpoint: time to first acute ILD exacerbation, first hospitalization for respiratory cause, or death (whichever occurs first) over the duration of the trial, Time to first acute Interstitial Lung Disease (ILD) exacerbation or death over the duration of trial, Time to hospitalization for respiratory cause or death over the duration of trial, Time to absolute decline in Forced vital capacity (FVC) % predicted of >10% from baseline or death over the duration of the trial, Time to absolute decline in Diffusing Capacity (of Lung) for Carbon Monoxide (DLCO) % predicted of >15% from baseline or death over the duration of the trial, Time to death over the duration of trial, Absolute change from baseline in Living with Pulmonary Fibrosis (L-PF) Symptoms Dyspnea domain score at Week 52, Absolute change from baseline in Living with Pulmonary Fibrosis (L-PF) Symptoms Cough domain score at Week 52, Absolute change from baseline in Living with Pulmonary Fibrosis (L-PF) Symptoms Fatigue domain score at Week 52, Absolute change from baseline in FVC % predicted at Week 52, Absolute change from baseline in DLCO % predicted at Week 52

Source: https://euclinicaltrials.eu/ctis-public/view/2024-512803-37-00